EU clinical trial 2023-508418-40-00: A Phase 1b/2, Open-label Study of Amivantamab Monotherapy and Amivantamab in Addition to Other Therapeutic Agents in Participants with Head and Neck Squamous Cell Carcinoma OrigAMI-4
Protocol code: 61186372HNC2002
Sponsor: Janssen Cilag International (Pharmaceutical company). Phase: Phase I and Phase II (Integrated)- Other. Countries: Poland (ongoing, recruiting), Germany (ongoing, recruiting), France (ongoing, recruiting), Spain (ongoing, recruiting).
Therapeutic area(s): Diseases [C] - Neoplasms [C04]
Gender: Female, Male. Age: 18-64 years, 65+ years. Enrolment: 55.
Status: Ongoing, recruiting. Start date (EU): 2024-12-16. Decision date: 2024-06-07. Results received: No. Last updated: 2026-01-19.
Decision dates by country: DE: 2024-06-10, PL: 2024-06-10, ES: 2024-06-07, FR: 2024-08-20

Condition(s): Head and Neck Squamous Cell Carcinoma
Product: Carboplatin Hikma 10 mg/ml Konzentrat zur Herstellung einer Infusionslösung, CARBO-cell® 10 mg/ml Infusionslösung, Konzentrat zur Herstellung einer Infusionslösung, JNJ-61186372, Carboplatin Kabi 10 mg/ml Konzentrat zur Herstellung einer Infusionslösung, KEYTRUDA 25 mg/mL concentrate for solution for infusion., KEYTRUDA 25 mg/mL concentrate for solution for infusion

Primary endpoint: Cohorts 1, 2, 3b and 5: ORR, according to RECIST v1.1. Cohort 3A: - Incidence of DLTs - Incidence and severity of TEAEs Cohort 6: - MPR

Source: https://euclinicaltrials.eu/ctis-public/view/2023-508418-40-00